EU clinical trial 2025-520710-58-00: The effect of Janus Kinase inhibitors on the heart in Rheumatoid Arthrtis
Protocol code: NL77572.029.21
Sponsor: Reade revalidatie & reumatologie centrum te Amsterdam (Hospital/Clinic/Other health care facility). Phase: Therapeutic use (Phase IV). Countries: Netherlands (ended).
Therapeutic area(s): Diseases [C] - Immune System Diseases [C20]; Diseases [C] - Cardiovascular Diseases [C14]
Gender: Female, Male. Age: 18-64 years, 65+ years. Enrolment: 105.
Status: Ended. Start date (EU): 2025-07-09. End date (EU): 2026-07-30. Decision date: 2025-01-28. Results received: No. Last updated: 2025-07-09.

Condition(s): Diagnosis of RA according to the ACR/EULAR 2010 criteria without a history of cardiovascular diseases, Rheumatroid Arthritis
Product: Jyseleca 200 mg film-coated tablets

Primary endpoint: The main study parameter is the change in LV function in RA patients after 1 year of treatment with filgotinib. LV function will be assessed at baseline and follow-up using CMR measurements of global circumferential, longitudinal and radial strain
Endpoint(s): The comparisons between baseline and follow-up data in RA patients treated with filgotinib for 1 year. And comparisons between RA patients and age- and sex-matched healthy volunteers. The first category is subdivided into endpoints derived from CMR, endpoints derived from CCTA, and endpoints concerning clinical treatment evaluation. The second category is subdivided into endpoints derived from CMR and endpoints derived from CCTA.

Source: https://euclinicaltrials.eu/ctis-public/view/2025-520710-58-00